EU clinical trial 2024-515530-33-00: PCA-oxycodone after cardiac surgery; respiratory effects, and short and long term outcome
Protocol code: 2024-515530-33-00
Sponsor: Pohjois-Savon hyvinvointialue (Patient organisation/association). Phase: Therapeutic use (Phase IV). Countries: Finland (ongoing, recruiting).
Therapeutic area(s): Analytical, Diagnostic and Therapeutic Techniques and Equipment [E] - Anesthesia and Analgesia [E03]
Gender: Female, Male. Age: 18-64 years, 65+ years. Enrolment: 100.
Status: Ongoing, recruiting. Start date (EU): 2025-03-23. Decision date: 2024-09-27. Results received: No. Last updated: 2024-09-27.

Condition(s): coronary artery disease; Aortic valve disease; Mitral valve disease; Tricuspidal valve disease or combination of the above
Product: Panadol Forte 1000 mg tabletti, kalvopäällysteinen, Oxanest® 10 mg/ml injektionsvätska, lösning

Primary endpoint: Nightly pulse oximetry desaturations: amount, depth, and time of recovery heir duration and respiratory rate. The connection of these changes to use of oxycodone PCA use.
Endpoint(s): Pain after cardiac surgery, morbidity, anxiety and depression, resilience, life satisfaction and heath related quality of life, Pain assessment daily with NRS at the hospital, Surgical complications with Clavien-Dindo classification, Pain outside hospital with Brief Pain Inventory (BPI)

Source: https://euclinicaltrials.eu/ctis-public/view/2024-515530-33-00